EU clinical trial 2024-520197-36-00: A Phase 1/2 First-Time-in-Human, open-label, multicenter, dose escalation and expansion study of the oral DNA Polymerase Theta Inhibitor (POLQi) GSK4524101 and the PARP inhibitor (PARPi) niraparib in adult participants with solid tumors.
Protocol code: 219590
Sponsor: Glaxosmithkline Research & Development Limited (Pharmaceutical company). Phase: Phase I and Phase II (Integrated)- First administration to humans. Countries: Estonia (ended), Czechia (ended), Spain (ended), Romania (ended), Italy (ended), Denmark (ended), Belgium (ended), Greece (ended).
Therapeutic area(s): Diseases [C] - Neoplasms [C04]
Gender: Female, Male. Age: 18-64 years, 65+ years. Enrolment: 31.
Status: Ended. End date (EU): 2025-12-09. Decision date: 2025-11-03. Results received: No. Last updated: 2025-11-10.
Decision dates by country: BE: 2025-11-03, CZ: 2025-11-04, DK: 2025-11-03, EE: 2025-11-04, GR: 2025-11-04, IT: 2025-11-03, RO: 2025-11-10, ES: 2025-11-07

Condition(s): Neoplasms
Product: Zejula 100 mg film-coated tablets, Zejula 100 mg film-coated tablets

Primary endpoint: Part 1 - Proportion of Participants with Dose Limiting Toxicities (DLTs) during DLT Observation Period, Part 1 - Proportion of Participants with Treatment Emergent Adverse Events (AEs) and Serious Adverse Events (SAEs) based on Severity during DLT Observation Period, Part 1 - Duration of Treatment Emergent AEs and SAEs (Days) during DLT Observation Period, Part 1 - Percentage of Participants who receive all Planned Doses during DLT Observation Period, Part 1 - Percentage of Participants who require dosage interruptions, dose reductions, and drug discontinuations due to adverse reactions during DLT Observation Period, Part 2 - Confirmed Objective Response Rate (ORR)
Endpoint(s): Part 1 - Area Under Curve (AUC), Time to Maximum Concentration, and half-life of GSK4364973, Part 1 and 2 - Maximum Concentration (Cmax) of GSK4364973, Part 1 and 2 - Plasma Concentration of Niraparib, Part 1 - Number of Participants with TEAEs and SAEs based on Severity beyond DLT Observation Period, Part 1 - Duration of TEAEs and SAEs (Days) beyond DLT Observation Period, Part 2 - Number of Participants with TEAEs and SAEs based on Severity, Part 2 - Duration of Treatment Emergent AEs and SAEs (Days), Part 2 - Progression-free Survival (PFS), Part 2 - Duration of Response (DOR), Part 2 - Minimum Concentration (Cmin) of GSK4364973

Source: https://euclinicaltrials.eu/ctis-public/view/2024-520197-36-00